EU clinical trial 2024-515686-34-00: A phase II study of Pembrolizumab plus Carboplatin in BRCA-related metastatic breast cancer
Protocol code: PEMBRACA
Sponsor: Azienda Ospedaliero Universitaria Di Modena (Hospital/Clinic/Other health care facility). Phase: Therapeutic exploratory (Phase II). Countries: Italy (ongoing, recruiting).
Therapeutic area(s): Diseases [C] - Neoplasms [C04]
Gender: Female, Male. Age: 18-64 years, 65+ years. Enrolment: 53.
Status: Ongoing, recruiting. Start date (EU): 2018-11-16. Decision date: 2024-11-12. Results received: No. Last updated: 2025-07-22.

Condition(s): BRCA-related metastatic breast cancer
Product: KEYTRUDA 25 mg/mL concentrate for solution for infusion, PEMBROLIZUMAB

Primary endpoint: The objective response rate

Source: https://euclinicaltrials.eu/ctis-public/view/2024-515686-34-00